EU clinical trial 2025-524112-11-00: J6Z-MC-IIBD - A Master Protocol for Phase 2, Randomized, Controlled Studies of Multiple Interventions for the Treatment of Adults With Moderately to Severely Active Ulcerative Colitis or Crohn’s Disease J6Z-MC-CD01 - A Phase 2, Multicenter, Randomized, Open-Label, Active-Controlled Study to Investigate LY4395089/Mirikizumab Co-administration Compared with Mirikizumab in Adults with Moderately to Severely Active Crohn’s Disease
Protocol code: J6Z-MC-CD01
Sponsor: Eli Lilly & Co. (Pharmaceutical company). Phase: Therapeutic exploratory (Phase II). Countries: Italy (authorised, recruitment pending), Germany (authorised, recruitment pending), Hungary (authorised, recruitment pending), Poland (authorised, recruitment pending), Belgium (authorised, recruitment pending).
Therapeutic area(s): Diseases [C] - Digestive System Diseases [C06]
Gender: Female, Male. Age: 18-64 years, 65+ years. Enrolment: 37.
Status: Authorised, recruitment pending. Decision date: 2026-06-11. Results received: No. Last updated: 2026-06-29.
Decision dates by country: BE: 2026-06-16, DE: 2026-06-22, HU: 2026-06-23, IT: 2026-06-11, PL: 2026-06-29

Condition(s): J6Z-MC-IIBD - Colitis, Ulcerative Crohn Disease J6Z-MC-CD01 - Crohn Disease
Product: Mirikizumab, Mirikizumab, Mirikizumab

Primary endpoint: J6Z-MC-CD01 - Percentage of Participants with Crohn’s Disease who Achieve Endoscopic Response, J6Z-MC-IIBD - The proportion of participants who achieve the following at Week 12 of Study Period 1: UC: endoscopic improvement CD: endoscopic response

Source: https://euclinicaltrials.eu/ctis-public/view/2025-524112-11-00